EU clinical trial 2024-518564-12-00: Antibiotic pharmacokinetics in women with twin pregnancy
Sponsor: Medical University Of Vienna (Educational Institution). Phase: Therapeutic use (Phase IV). Countries: Austria (ongoing, recruiting).
Therapeutic area(s): Diseases [C] - Bacterial Infections and Mycoses [C01]
Gender: Female. Age: 18-64 years. Enrolment: 92.
Status: Ongoing, recruiting. Start date (EU): 2023-01-05. Decision date: 2024-12-11. Results received: No. Last updated: 2025-10-06.

Condition(s): Pregnancy
Product: Kefzol 2 g – Trockensubstanz zur Infusionsbereitung, Standacillin 2 g – Pulver zur Herstellung einer Injektions-/Infusionslösung, Dalacin C® Phosphat 600 mg/4 ml – Ampulle, Piperacillin/Tazobactam Sandoz 4,0 g/0,5 g - Pulver zur Herstellung einer Infusionslösung

Primary endpoint: Pharmacokinetic: Differences in antibiotic concentration between twin pairs, Antibiotic cord/maternal ratio, The maternal antibiotic volume of distribution (Vd), clearance (Cl), Protein binding (PB), Placenta interstitial fluid concentration, Umbilical cord antibiotic concentration
Endpoint(s): Clinical descriptive endpoints: Maternal postoperative infection or sepsis, Early-onset neonatal sepsis., Safety endpoints: Safety and tolerability of the antibiotics will be collected to define any adverse drug reaction (clinically observed, haematological or biochemical) that is reported by the clinical staff that is suspected as being caused by any of the study antibiotics., Substudy endpoints: Differences in antibiotic concentration between monochorionic and dichorionic twin pairs

Source: https://euclinicaltrials.eu/ctis-public/view/2024-518564-12-00